EU clinical trial 2025-520923-25-00: Trial of Sequential Medications AfteR TNFi Failure in Juvenile Idiopathic Arthritis (SMART-JIA)
Protocol code: SMART-JIA
Sponsor: Duke Clinical Research Institute (Laboratory/Research/Testing facility). Phase: Therapeutic confirmatory (Phase III). Countries: Italy (authorised, recruitment pending), Netherlands (authorised, recruitment pending), Germany (authorised, recruitment pending).
Therapeutic area(s): Diseases [C] - Immune System Diseases [C20]
Gender: Female, Male. Age: 0-17 years. Enrolment: 45.
Status: Authorised, recruitment pending. Decision date: 2026-02-10. Results received: No. Last updated: 2026-02-24.
Decision dates by country: IT: 2026-02-10, NL: 2026-02-16, DE: 2026-02-11

Condition(s): Juvenile Idiopathic Arthritis
Product: Humira 40 mg solution for injection in pre-filled syringe, ORENCIA 50 mg solution for injection in pre-filled syringe, Tyenne 162mg/0.9ml solution for injection in pre-filled syringe, Humira 20 mg solution for injection in pre-filled syringe, XELJANZ 1 mg/mL oral solution, Enbrel 50 mg solution for injection in pre-filled syringe, Enbrel 25 mg solution for injection in pre-filled syringe, ORENCIA 125 mg solution for injection in pre-filled syringe, XELJANZ 5 mg film-coated tablets, ORENCIA 87.5 mg solution for injection in pre-filled syringe

Primary endpoint: Minimal disease activity (MiDA) at Month 6 as assessed by the cJADAS10 less than or equal to 5
Endpoint(s): PROMIS® pain interference at Month 6, PROMIS® fatigue at Month 6, PROMIS® mobility at Month 6, Change in arthritis disease activity (cJADAS10 and JIA American College of Rheumatology Pediatric 70 [ACR 70]) at Month 6, Change in arthritis disease activity (cJADAS10) at Month 12

Source: https://euclinicaltrials.eu/ctis-public/view/2025-520923-25-00